EU clinical trial 2023-503913-31-01: The use of sildenafil in patients with univentricular heart after Fontan operation - a pilot SINFON-POL study.
Protocol code: 2.16/VI/22
Sponsor: National Institute Of Cardiology (Hospital/Clinic/Other health care facility). Phase: Therapeutic confirmatory (Phase III). Countries: Poland (ongoing, recruiting).
Therapeutic area(s): Diseases [C] - Cardiovascular Diseases [C14]; Phenomena and Processes [G] - Physiological processes [G07]; Diseases [C] - Congenital, Hereditary, and Neonatal Diseases and Abnormalities [C16]; Phenomena and Processes [G] - Circulatory and Respiratory Physiological Phenomena [G09]
Gender: Female, Male. Age: 18-64 years, 65+ years. Enrolment: 60.
Status: Ongoing, recruiting. Start date (EU): 2025-06-27. Decision date: 2024-09-22. Results received: No. Last updated: 2025-07-22.

Condition(s): Patients with functionally single ventricle (FSV - functionally single ventricle) after Fontan operation. The term "functionally single ventricle" refers to congenital heart defects in which one of the ventricles is not fully developed and/or one of the valves is atresia/hypoplastic as a result, it is not possible to correct the intracardiac defect. Then, there are indications for the Fontan operation, i.e. a palliative procedure - total cavo-pulmonary connection (TCPC). In patients with a functionally single ventricle, more than one operation is necessary to separate the systemic and pulmonary circulation. As a result of these procedures, Fontan circulation is created, which consists in bypassing the right heart chambers and directing the venous blood to the pulmonary artery. This leads to the removal of the right-to-left shunt and improvement of arterial blood saturation and reduction of volume overload of the systemic ventricle. At the same time, there is an increase in systemic venous pressure and a decrease in cardiac output. Low pulmonary resistance in these patients is crucial for maintaining optimal hemodynamic conditions both at rest and especially during exercise. Even a slight increase in pulmonary resistance leads to reduced pulmonary blood flow, reduced initial depression of a single ventricle, and consequently to reduced cardiac output and worsened exercise tolerance. Thus, pulmonary resistance in these patients should be not only normal, but also as low as possible to ensure adequate single ventricular filling and adequate cardiac output. There is evidence that patients with Fontan surgery increase pulmonary resistance over time. The increase in pulmonary resistance in these patients may result from several factors, and above all from the progressive dysfunction of a single systemic ventricle and the lack of a subpulmonary chamber ensuring pulsatile pulmonary flow. Although the Fontan operation in many patients with an univentricular heart is a very good method of palliative treatment, which undoubtedly extends the survival of children born with this heart defect, it also inevitably leads to severe complications developing over the years. Patients after the Fontan operation are also characterized by a significant reduction in exercise capacity, which is observed both in clinical practice in reference centres dealing with patients with congenital heart defects, and in multi-centre studies. Among other things, it was shown that children after the Fontan operation obtained 30% lower values of peak oxygen uptake in the ergospirometric test compared to the control group of healthy children (Amadero P et al., Heart 2018). The reduced exercise capacity of patients and the development of Fontan circulatory complications affect both the quality of life and the prognosis of adult patients with univentricular heart.
Product: Sildenafil placebo, Remidia, 20 mg, tabletki powlekane

Primary endpoint: Increase in peak oxygen uptake (V02max) in ergospirometry test after 24 weeks of treatment
Endpoint(s): Increase in the amount of exercise performed, measured in metabolic equivalents (METS) during cardiopulmonary exercise testing (CPET) after 24 weeks of treatment, Increase in the distance covered in the 6-minute walk test (6MWT), Increase in the absolute value of global longitudinal strain (GLS) in echocardiography after 24 weeks of treatment, Reduction in serum Nt-proBNP levels after 24 weeks of treatment, Reduction in fibrosis score on elastography (abdominal ultrasound) after 24 weeks of treatment, Increase in the quality of life index as assessed by the SF-36 questionnaire after 24 weeks of treatment

Source: https://euclinicaltrials.eu/ctis-public/view/2023-503913-31-01